EU clinical trial 2024-519104-27-00: Potential of FX06 to improve disease severity in Acute Respiratory Distress Syndrome patients (Ixion 2.0)
Protocol code: TMP-2204-2021-47
Sponsor: F4-Pharma Ges.m.b.H. (Pharmaceutical company). Phase: Therapeutic exploratory (Phase II). Countries: Spain (ended), France (ended), Romania (ended), Germany (ended), Lithuania (ended).
Therapeutic area(s): Diseases [C] - Respiratory Tract Diseases [C08]
Gender: Female, Male. Age: 18-64 years, 65+ years. Enrolment: 263.
Status: Ended. Start date (EU): 2022-03-08. End date (EU): 2025-03-31. Decision date: 2024-11-25. Results received: Yes. Last updated: 2024-12-09.
Decision dates by country: FR: 2024-12-02, DE: 2024-11-26, LT: 2024-11-28, RO: 2024-12-09, ES: 2024-11-25

Condition(s): Acute Respiratory Distress Syndrome (ARDS)
Product: phosphate buffered saline., FX06

Primary endpoint: The primary objective is to demonstrate a difference in the time to initial unassisted breathing (UAB) in patients receiving FX06 compared to patients receiving placebo until day 28. • Time to initial unassisted breathing (UAB) until day 28 in both treatment groups
Endpoint(s): at all available visits and time points between the FX06 and placebo group • Disease progression/improvement, Lung function (partial oxygen pressure in the blood, fraction of inspired oxygen, Horowitz index) at BL, D3, D6, D10 and D28, Systemic inflammation (changes and normalisation in troponin, procalcitonin, CRP, leukocyte count, ferritin, D-dimers, lactate, lactate dehydrogenase, albumin, IL-6), Survival / Mortality, Capillary refill time, Duration of hospital and ICU stay, Subgroup analysis by concomitant medication, age, sex, and ARDS cause, Safety parameters (evaluated for safety set)

Source: https://euclinicaltrials.eu/ctis-public/view/2024-519104-27-00